EU clinical trial 2024-518160-13-00: MESENCHYMAL STROMAL CELL THERAPY FOR THE TREATMENT OF ACUTE RESPIRATORY DISTRESS SYNDROME - Validation of Mechanistic Pathways and Clinical Efficacy
Protocol code: ARDS-MSC-205
Sponsor: Region Uppsala (Hospital/Clinic/Other health care facility). Phase: Human Pharmacology (Phase I)- First administration to humans. Countries: Sweden (ended).
Therapeutic area(s): Diseases [C] - Virus Diseases [C02]
Gender: Female, Male. Age: 18-64 years, 65+ years. Enrolment: 7.
Status: Ended. End date (EU): 2026-04-15. Decision date: 2024-10-25. Results received: No. Last updated: 2024-10-25.

Condition(s): Acute Respiratory Distress Syndrome - ARDS

Source: https://euclinicaltrials.eu/ctis-public/view/2024-518160-13-00